EU clinical trial 2022-501649-54-01: Dapiglutide for the treatment of obesity (DREAM): a randomised, double-blind, placebo-controlled, investigator-initiated trial
Protocol code: The ‘DREAM’ trial
Sponsor: Gentofte Hospital (Hospital/Clinic/Other health care facility). Phase: Therapeutic exploratory (Phase II). Countries: Denmark (ended).
Therapeutic area(s): Diseases [C] - Nutritional and Metabolic Diseases [C18]
Gender: Female, Male. Age: 18-64 years. Enrolment: 54.
Status: Ended. End date (EU): 2024-04-24. Decision date: 2023-02-07. Results received: Yes. Last updated: 2023-12-17.

Condition(s): Obesity
Product: Placebo for dapiglutide

Primary endpoint: Change in body weight
Endpoint(s): Body weight reduction ≥ 5%, Body weight reduction ≥ 5%, Change in fasting serum/plasma concentrations of gut permeability biomarkers • LPS, Change in fasting serum/plasma concentrations of inflammation markers. High-sensitivity CRP. Interleukin (IL)-6

Source: https://euclinicaltrials.eu/ctis-public/view/2022-501649-54-01